EU clinical trial 2023-505098-34-00: A Phase IV Longitudinal Study of SUBLOCADE (SUBUTEX Prolonged Release) Clinical Outcomes in Adults with Opioid Use Disorder (Opioid Dependence)
Protocol code: INDV-6000-406
Sponsor: Indivior Inc. (Pharmaceutical company). Phase: Therapeutic use (Phase IV). Countries: Sweden (ended).
Therapeutic area(s): Psychiatry and Psychology [F] - Mental Disorders [F03]
Gender: Female, Male. Age: 18-64 years, 65+ years. Enrolment: 50.
Status: Ended. Start date (EU): 2024-04-22. End date (EU): 2025-08-31. End date: 2025-09-01. Decision date: 2024-02-15. Results received: No. Last updated: 2025-04-29.

Condition(s): Opioid Use Disorder
Product: Subutex 300 mg injektionsvätska, depotlösning, Subutex 100 mg injektionsvätska, depotlösning

Primary endpoint: Participants achieving DSM-5 remission, early or sustained, (yes/no) while on initial SUBLOCADE treatment by 6 months and 1, 1.5, 2, 2.5, and 3 years from study Baseline
Endpoint(s): Participants with “no symptoms”or improving by ≥1 DSM-5 severity classification within the last 3 months (moderate to mild, or severe to mild or moderate) relative to study Baseline (yes/no) at Month 6 and Years 1, 2, and 3 (Key Secondary Endpoint), Among those starting SUBLOCADE within 3 months of study Baseline, time to achieve early remission for the first time while on initial SUBLOCADE treatment, Participants achieving DSM-5 sustained remission (yes/no) by 1, 1.5, 2, 2.5, and 3 years while on initial SUBLOCADE treatment, Time to achieve sustained remission for the first time while on initial SUBLOCADE treatment, Time to discontinuing initial SUBLOCADE treatment and the corresponding reasons for discontinuation, eg, resolution of OUD (Opioid Use Disorder) symptoms, safety concerns, treatment failure, or seeking alternative MOUD (Moderate Opioid Use Disorder) treatment, Participants switching from initial SUBLOCADE treatment to another MOUD (yes/no), and the corresponding reasons, eg, safety concerns, treatment failure, seeking alternative MOUD treatment, The overall treatment duration for participants who stop initial SUBLOCADE treatment as the result of resolution of OUD symptoms, Participants with any positive opioid use in the past month (yes/no) at Month 6 and Years 1, 2, and 3 while on initial SUBLOCADE treatment, Participants with opioid overdose requiring intervention (yes/no) while on initial SUBLOCADE treatment at least once during the first 6 months, and during Years 1, 2, and 3

Source: https://euclinicaltrials.eu/ctis-public/view/2023-505098-34-00